EU clinical trial 2025-521090-14-00: A Phase 2, single arm Multicenter, Study testing Mezigdomide, Carfilzomib, and Dexamethasone (480Kd) in Participants with Relapsed or Refractory Multiple Myeloma (RRMM). (MEZI-KD)
Sponsor: Assistance Publique Hopitaux De Paris (Hospital/Clinic/Other health care facility). Phase: Therapeutic exploratory (Phase II). Countries: France (authorised, recruitment pending).
Therapeutic area(s): Diseases [C] - Hemic and Lymphatic Diseases [C15]; Diseases [C] - Neoplasms [C04]
Gender: Female, Male. Age: 18-64 years, 65+ years. Enrolment: 70.
Status: Authorised, recruitment pending. Decision date: 2026-04-08. Results received: No. Last updated: 2026-04-20.
Decision dates by country: FR: 2026-04-20

Condition(s): Patients with relapsed/refractory symptomatic multiple myeloma (MM)
Product: DEXAMETHASONE, CARFILZOMIB, DEXAMETHASONE, DEXAMETHASONE, CC-92480

Primary endpoint: The progression-free survival defined as the time from inclusion to first documentation of progressive disease (PD) according to the International Myeloma Working Group (IMWG) Uniform Response Criteria for Multiple Myeloma or death due to any cause, whichever occurs first
Endpoint(s): Overall Survival (OS) defined as the time from inclusion to time of death due to any cause, Overall Response Rate (ORR) defined as the percentage of participants who achieve best response of partial response (PR) or better according to the IMWG Uniform Response Criteria for Multiple Myeloma, Rate of very good partial response (VGPR) or better (VGPRR) defined as the percentage of participants who achieve best response of VGPR or better according to the IMWG Uniform Response Criteria for Multiple Myeloma, Rate of complete response (CR) or better (CRR) defined as the percentage of participants who achieve best response of CR or better according to the IMWG Uniform Response Criteria for Multiple Myeloma, Time to Response (TTR) defined as the time from inclusion on to the first documentation of response (PR or better), Duration of Response (DOR) defined as the time from the first documentation of response (PR or better) to the first documentation of progressive disease (PD) or death due to any cause, whichever occurs first, Time to Progression (TTP) defined as the time from inclusion to the first documentation of PD, Time to Next Treatment (TTNT) defined as the time from inclusion to the start of the next anti-myeloma treatment, To evaluate minimal residual disease (MRD) negativity rate in participants treated with 480Kd defined as the proportion of participants who achieve CR or better and are MRD negative (defined at a sensitivity of a minimum of 1 in 105 nucleated cells), To evaluate safety of 480Kd in participants with RRMM, defined as the type, frequency, seriousness and severity of adverse events (AEs), and relationship of AEs to study treatment, To evaluate cancer and multiple myeloma-related symptoms and health-related quality of life (HRQoL) using the European Organization for Research and Treatment of Cancer - Quality of Life C30 questionnaire (EORTC QLQ-C30) and the European Quality of Life Multiple Myeloma module (EORTC QLQ-MY20) in participants treated with 480Kd

Source: https://euclinicaltrials.eu/ctis-public/view/2025-521090-14-00